EU clinical trial 2023-504745-31-00: Incidence of postoperative residual neuromuscular blockade following the administration of rocuronium in thoracic surgical patients: a randomized placebo controlled study
Protocol code: AITT2023/3
Sponsor: University Of Debrecen (Educational Institution). Phase: Therapeutic use (Phase IV). Countries: Hungary (ongoing, recruiting).
Therapeutic area(s): Not possible to specify
Gender: Female, Male. Age: 18-64 years. Enrolment: 75.
Status: Ongoing, recruiting. Start date (EU): 2024-06-18. Decision date: 2024-06-12. Results received: No. Last updated: 2024-06-18.

Condition(s): Anesthesia and Analgesia, patient safety

Source: https://euclinicaltrials.eu/ctis-public/view/2023-504745-31-00